EU clinical trial 2022-502053-34-00: Dose-Escalation Study of Cevostamab in Participants with Relapsed or Refractory Multiple Myeloma
Protocol code: GO39775
Sponsor: Genentech Inc. (Pharmaceutical company). Phase: Human Pharmacology (Phase I)- First administration to humans. Countries: Spain (ended).
Therapeutic area(s): Diseases [C] - Neoplasms [C04]
Gender: Female, Male. Age: 18-64 years, 65+ years. Enrolment: 20.
Status: Ended. Start date (EU): 2020-07-13. End date (EU): 2025-07-10. End date: 2026-01-07. Decision date: 2024-02-27. Results received: No. Last updated: 2025-10-30.

Condition(s): Multiple Myeloma (MM)

Source: https://euclinicaltrials.eu/ctis-public/view/2022-502053-34-00